EU clinical trial 2024-519116-14-00: A Phase IIb, Multicentre, Double-blind, Placebo-controlled Dose Range Finding Study to Assess Efficacy and Safety of Tozorakimab in Adult Participants with Uncontrolled Asthma on Medium-to-High Dose Inhaled Corticosteroids (UMBRIEL)
Protocol code: D9181C00002
Sponsor: AstraZeneca AB (Pharmaceutical company). Phase: Therapeutic exploratory (Phase II). Countries: France (ongoing, recruiting), Italy (ongoing, recruiting), Greece (ongoing, recruitment ended), Spain (ongoing, recruiting), Hungary (ongoing, recruitment ended).
Therapeutic area(s): Diseases [C] - Respiratory Tract Diseases [C08]
Gender: Female, Male. Age: 18-64 years, 65+ years. Enrolment: 70.
Start date (EU): 2025-05-27. Decision date: 2025-04-03. Results received: No. Last updated: 2026-01-19.
Decision dates by country: ES: 2025-04-03, GR: 2025-04-24, IT: 2025-04-18, HU: 2025-05-07, FR: 2025-04-04

Condition(s): Asthma
Product: Tozorakimab-placebo, Tozorakimab, SALBUTAMOL

Primary endpoint: Annualised rate of severe asthma exacerbations.
Endpoint(s): 1. Annualised rate of severe asthma exacerbations (in participants with uncontrolled moderate-to-severe asthma and baseline eosinophils <300 cells/μL and history of ≥2 exacerbations within 12 months prior to screening)., 2. Time-to-first severe asthma exacerbation., 3. Change from baseline in pre-bronchodilator forced expiratory volume in 1 second (FEV1) over weeks 20-26., 4. Change from baseline in post-bronchodilator FEV1 at week 26., 5. Change from baseline in ACQ-6 at week 26., 6. Change from baseline in AQLQ(S)+12 at week 26., 7. Trough serum concentrations of tozorakimab over 52 weeks treatment period., 8. Anti-drug antibody (ADA) prevalence, incidence, and titre.

Source: https://euclinicaltrials.eu/ctis-public/view/2024-519116-14-00